EU clinical trial 2024-515142-16-00: BORTEZOMIB SENSITIZATION OF RECURRENT GRADE-4 GLIOMA WITH UNMETHYLATED MGMT PROMOTER TO TEMOZOLOMIDE. PHASE IB/II. (BORTEM 17)
Sponsor: Helse Bergen HF (Hospital/Clinic/Other health care facility). Phase: Phase I and Phase II (Integrated)- First administration to humans. Countries: Norway (ongoing, recruiting).
Therapeutic area(s): Diseases [C] - Neoplasms [C04]
Gender: Female, Male. Age: 18-64 years, 65+ years. Enrolment: 63.
Status: Ongoing, recruiting. Start date (EU): 2024-10-03. Decision date: 2024-10-02. Results received: No. Last updated: 2026-02-05.

Condition(s): Grade IV recurrent glioma which includes both glioblastoma, classified as IDH wt and grade IV IDH mutated astrocytoma.
Product: Bortezomib Accord 2.5 mg/mL solution for injection, Temozolomide SUN 180 mg hard capsules, Temozolomide SUN 250 mg hard capsules, Bortezomib Viatris 3,5 mg pulver til injeksjonsvæske, oppløsning, Temozolomide Accord 100 mg hard capsules., Temozolomide Accord 140 mg hard capsules., Temozolomide Accord 20 mg hard capsules., Temozolomide SUN 100 mg hard capsules, Temozolomide Accord 180 mg hard capsules., Temozolomide SUN 140 mg hard capsules

Primary endpoint: Phase IB of the trial: Assessment of safety and tolerability of Bortezomib administered with Temozolomide., Phase II: Assessment of efficacy of Temozolomide administered together with Bortezomib in recurrent glioblastoma. Overall survival (OS) at 1 year. Median OS from the 1st relapse. Progression free survival at 6 months. Median PFS from the 1st relapse. Time to progression.
Endpoint(s): Tumour response as assessed by contrast enhanced MRI using RANO criteria and neurological exam, [Time Frame: MRI at start of treatment and every 12th week, neurologic exam every 4 weeks]. If disease progression is suspected according to NANO criteria (clinical assessment) further confirmation with MRI (RANO) is required., Neurologic assessment according to NANO criteria [Time Frame: neurologic exam every 4 weeks], Identification of novel tumor biomarkers by determining physiological, molecular and biochemical changes in blood and tumor tissue that correlate with treatment responses

Source: https://euclinicaltrials.eu/ctis-public/view/2024-515142-16-00